EU clinical trial 2025-524613-89-00: PHASE IB/II STUDY TO EVALUATE SAFETY AND PRELIMINARY EFFICACY OF ZANIDATAMAB IN COMBINATION WITH TUCATINIB AND CHEMOTHERAPY (CAPECITABINE OR ERIBULIN MESYLATE) IN HER2-POSITIVE ADVANCED BREAST CANCER (The JAZMINE Study)
Protocol code: MEDOPP0776
Sponsor: Medica Scientia Innovation Research S.L. (Pharmaceutical company). Phase: Phase I and Phase II (Integrated)- Other. Countries: Spain (ongoing, recruiting).
Therapeutic area(s): Diseases [C] - Neoplasms [C04]
Gender: Female, Male. Age: 18-64 years, 65+ years. Enrolment: 129.
Status: Ongoing, recruiting. Start date (EU): 2026-07-15. Decision date: 2026-05-05. Results received: No. Last updated: 2026-07-10.

Condition(s): HER2 positive advanced breast cancer
Product: paracetamol cinfa 1 g comprimidos EFG, Dexamethasone Phosphate 4mg/ml Solution for Injection or Infusion, Capecitabina Glenmark 150 mg comprimidos recubiertos con película EFG, Soñodor difenhidramina 50 mg comprimidos, HYDROCORTISONE PHARMIS 100 mg, poudre et solvant pour solution injectable/pour perfusion, Paracetamol Cinfa 650 mg comprimidos EFG, Loperan 2 mg cápsulas duras., ZANIDATAMAB, Eribulin Baxter 0.44 mg/mL solution for injection, TUKYSA 50 mg film-coated tablets, TUKYSA 150 mg film-coated tablets, Capecitabina Glenmark 500 mg comprimidos recubiertos con película EFG

Primary endpoint: PHASE Ib: The maximum tolerated dose (MTD) of zanidatamab administered in combination with tucatinib and capecitabine, as determined by the proportion of DLTs observed. The RP2D will be established based on the MTD, the overall safety and tolerability profile and early efficacy data (Cohort A)., PHASE Ib: The MTD of zanidatamab administered in combination with tucatinib and eribulin, as determined by the proportion of DLTs observed. The RP2D will be established based on the MTD, the overall safety and tolerability profile and early efficacy data (Cohort B).., PHASE II: PFS, defined as the period from treatment initiation to the first occurrence of documented radiographic disease progression or death from any cause, whichever occurs first, as assessed by the Investigator per RECIST v.1.1 (Arm A).
Endpoint(s): PHASE Ib: ORR, defined as the number of participants with CR or PR, divided by the number of participants in the analysis population, as assessed by the Investigator per RECIST v.1.1 (Cohort A and B), PHASE Ib: IC-ORR, defined as the percentage of participants with IC CR or PR, divided by the number of participants in the analysis population, assessed by the Investigator per RANO-BM criteria (Cohort A and B only in participants with BM)., PHASE Ib: PFS, defined as the period from Study treatment initiation to the first occurrence of documented radiographic disease progression or death from any cause, whichever occurs first, as assessed by the investigator using RECIST v.1.1. criteria (Cohort A and B)., PHASE Ib: IC-PFS, defined as the period from treatment initiation to the first occurrence of documented radiographic intracranial progression or death from any cause, whichever occurs first, as assessed by the Investigator per RANO-BM criteria. (Cohort A and Bonly in participants with BM), PHASE II: IC-PFS, defined as the period from treatment initiation to the first occurrence of documented radiographic intracranial progression or death from any cause, whichever occurs first, as assessed by the Investigator per RANO-BM criteria (Arm A and B only in participants with BM)., PHASE II: IC-ORR at 3 months, defined as the percentage of participants with intracranial complete response (CR) or partial response (PR), divided by the number of participants in the analysis population, as assessed by the Investigator per RANO-BM criteria (Arm A and Arm B; only in participants with BM).., PHASE II: ORR, defined as the number of participants with CR or PR, divided by the number of participants in the analysis population, as assessed by the Investigator per RECIST v.1.1 (Arm A and Arm B)., PHASE II: PFS, defined as the period from Study treatment initiation to the first occurrence of documented radiographic disease progression or death from any cause, whichever occurs first, as assessed by the investigator using RECIST v.1.1. criteria (Arm B)., PHASE II: TTR, defined as the period from start of treatment to time of the first objective tumor response (tumor shrinkage of ≥ 30%) observed for participants who achieved a best overall response of CR or PR, based on local Investigator assessment as per RECIST v.1.1 overall lesions (Arm A and Arm B), PHASE II: DoR, defined as the period from the first occurrence of a documented objective response to disease progression or death from any cause, whichever occurs first, based on local Investigator assessment as per RECIST v.1.1 overall lesions (Arm A and Arm B)., PHASE II: CBR, defined as the rate of participants with an objective response (CR or PR), or stable disease for at least 24 weeks, based on local Investigator assessment as per RECIST v.1.1 overall lesions (Arm A and Arm B).., PHASE II: Best percentage change from baseline in the size of target lesion (RECIST v.1.1 assessment performed by CT). The best percentage change is defined as the biggest decrease, or the smallest increase if no decrease (Arm A and Arm B)..

Source: https://euclinicaltrials.eu/ctis-public/view/2025-524613-89-00